EU clinical trial 2023-509856-32-00: AIEOP-BFM ALL 2017 - International collaborative treatment protocol for children and adolescents with acute lymphoblastic leukemia
Protocol code: AIEOP-BFM_ALL_2017
Sponsor: Universitaetsklinikum Schleswig-Holstein (Hospital/Clinic/Other health care facility). Phase: Therapeutic confirmatory (Phase III). Countries: Austria (ongoing, recruitment ended), Slovakia (ongoing, recruitment ended), Czechia (ongoing, recruitment ended), Italy (ongoing, recruitment ended), Germany (ongoing, recruitment ended).
Therapeutic area(s): Diseases [C] - Neoplasms [C04]; Diseases [C] - Hemic and Lymphatic Diseases [C15]
Gender: Female, Male. Age: 0-17 years. Enrolment: 4250.
Status: Ongoing, recruitment ended. Start date (EU): 2018-07-15. Decision date: 2024-07-05. Results received: No. Last updated: 2026-06-26.
Decision dates by country: IT: 2024-07-09, SK: 2024-07-08, AT: 2024-07-09, CZ: 2024-07-08, DE: 2024-07-05

Condition(s): acute lymphoblastic leukemia in children and adolescents
Product: Erwinase, 10,000 IU/vial, Powder for solution for injection/infusion., ETOPOSIDE, IFOSFAMIDE, VINCRISTINE, PREDNISOLONE, BORTEZOMIB, VINDESINE, CYCLOPHOSPHAMIDE, Oncaspar 750 U/ml powder for solution for injection/infusion., DAUNORUBICIN, FLUDARABINE, METHOTREXATE, Myocet 50 mg powder, dispersion and solvent for concentrate for dispersion for infusion, BLINCYTO 38.5 micrograms powder for concentrate and solution for solution for infusion., DEXAMETHASONE, DOXORUBICIN, ETOPOSIDE PHOSPHATE, CYTARABINE, METHOTREXATE, PREDNISONE, MERCAPTOPURINE, TIOGUANINE

Primary endpoint: For the randomized study questions, the primary endpoint will be the time from randomization until the first event defined as follows: Randomization R-eHR, R-HR and R-T: Cytomorphological or molecular non-response (resistance to protocol treatment, considered as event at day zero), relapse, second malignancy or death from any cause. This will be called EFS time., Randomization R-MR: Relapse, second malignancy or death from any cause. This will be called DFS time., EFS and DFS time: end of study
Endpoint(s): Survival starting at the same time point as the EFS/DFS, Frequency and incidence of treatment-related mortality in induction or CCR, Frequency and incidence of AE of interest and SAE in specific protocol phases, randomized arms and overall during follow-up, MRD load after the randomized treatment phases (R-eHR, R-HR, R-MR and R-T), MRD load after the first/second cycle of Blinatumomab or after the HR 2'/HR 3' block (R-HR), Proportion of patients with poor MRD response to the first Blinatumomab cycle ("Blinatumomab Poor-Response") (R HR)

Source: https://euclinicaltrials.eu/ctis-public/view/2023-509856-32-00